EU clinical trial 2025-522503-18-00: Semaglutide and Finerenone for Kidney and Vascular Protection in CKD
Protocol code: SAFE-K
Sponsor: Region Midtjylland (Hospital/Clinic/Other health care facility). Phase: Therapeutic use (Phase IV). Countries: Denmark (ongoing, recruiting).
Therapeutic area(s): Diseases [C] - Pathological Conditions, Signs and Symptoms [C23]
Gender: Female, Male. Age: 18-64 years, 65+ years. Enrolment: 160.
Status: Ongoing, recruiting. Start date (EU): 2025-10-27. Decision date: 2025-09-09. Results received: No. Last updated: 2025-09-09.

Condition(s): Chronic kidney disease
Product: Ozempic 1 mg solution for injection in pre-filled pen, Ozempic 0.5 mg solution for injection in pre-filled pen, Ozempic 0.25 mg solution for injection in pre-filled pen, Kerendia 10 mg film coated tablets, Kerendia 20 mg film-coated tablets, Ozempic 0.5 mg solution for injection in pre-filled pen, Kerendia 10 mg film coated tablets, Kerendia 20 mg film-coated tablets

Primary endpoint: The difference in the change in urine albumin-to-creatinine ratio (UACR), based on the average of two morning spot urine samples, between the two groups, measured from baseline to the end of both intervention periods (Intervention period I: semaglutide vs. control, followed by Intervention period II: additional finerenone for all participants).
Endpoint(s): Change in urine albumin-to-creatinine ratio from baseline to end of both intervention periods., Change in urine albumin-to-creatinine ratio from baseline to 20 weeks semaglutide treatment., Change in urine albumin-to-creatinine ratio from baseline to end of combination therapy (semaglutide followed by additional finerenone), compared to the change during semaglutide treatment alone.

Source: https://euclinicaltrials.eu/ctis-public/view/2025-522503-18-00